EU clinical trial 2026-526084-38-00: REpurposed drug evaluation for DEceleration of immunE aging & Mitigation of chronic inflammation (REDEEM)
Sponsor: Radboud universitair medisch centrum Stichting (Hospital/Clinic/Other health care facility). Phase: Therapeutic exploratory (Phase II). Countries: Netherlands (authorised, recruitment pending).
Therapeutic area(s): Diseases [C] - Immune System Diseases [C20]; Phenomena and Processes [G] - Immune system processes [G12]
Gender: Female, Male. Age: 18-64 years, 65+ years. Enrolment: 150.
Status: Authorised, recruitment pending. Decision date: 2026-06-08. Results received: No. Last updated: 2026-06-08.

Condition(s): Immune Aging, Chronic inflammation

Source: https://euclinicaltrials.eu/ctis-public/view/2026-526084-38-00